EU clinical trial 2025-520783-17-01: Shared decision-making in uncomplicated appendicitis: a pragmatic randomized trial comparing patient-driven choice (antibiotics only or appendectomy) with systematic appendectomy (FRENCH 47 — ALACARTE trial)
Sponsor: Assistance Publique Hopitaux De Paris (Hospital/Clinic/Other health care facility). Phase: Therapeutic exploratory (Phase II). Countries: France (authorised, recruitment pending).
Therapeutic area(s): Analytical, Diagnostic and Therapeutic Techniques and Equipment [E] - Therapeutics [E02]; Diseases [C] - Digestive System Diseases [C06]; Analytical,Diagnostic,Therapeutic Techniques and Equipment [E]-Surgical Procedures, Operative [E04]
Gender: Female, Male. Age: 18-64 years, 65+ years. Enrolment: 560.
Status: Authorised, recruitment pending. Decision date: 2026-07-06. Results received: No. Last updated: 2026-07-06.

Condition(s): Adult patients diagnosed with uncomplicated acute appendicitis
Product: AMOXICILLIN AND BETA-LACTAMASE INHIBITOR

Primary endpoint: The presence of regret about the initial treatment one year after its initiation will be assessed by the answer at the question “You were initially treated for your appendicitis (infection of the appendix) either by surgery with removal of the appendix (appendectomy) or by antibiotic therapy alone without surgery initially. Do you regret the treatment you received? YES - NO."
Endpoint(s): 1/ Patient’s symptom persistence or recurrence at 12 months. Proportion of patients with at least one symptom persistence or recurrence at 12 months., 2/ Patient’s quality of life at 12 months. Quality of life assessed by the EQ-5D-5L questionnaire using the French value set for scoring heath states and fulfilled by the participants (appendix 2)., 3/ The regret at 12 months assessed by the validated decisional regret scale. This standardized scale allows quantifying treatment regret by a score ranging from 0 for no regret to 100 for maximum regret.

Source: https://euclinicaltrials.eu/ctis-public/view/2025-520783-17-01